EU clinical trial 2023-504027-78-00: A Phase II, Randomized, Multicenter, Open-Label, Controlled Study of Tobemstomig Alone or in Combination With Tiragolumab Versus Atezolizumab in Patients With Previously Untreated Locally Advanced or Metastatic Urothelial Cancer Who Are Ineligible for Platinum-Containing Chemotherapy
Protocol code: BO44157
Sponsor: F. Hoffmann-La Roche AG (Pharmaceutical company). Phase: Therapeutic exploratory (Phase II). Countries: Spain (ongoing, recruitment ended), Germany (ended), Denmark (ended), Poland (ongoing, recruitment ended), France (ongoing, recruitment ended), Italy (ended), Greece (ongoing, recruitment ended).
Therapeutic area(s): Diseases [C] - Neoplasms [C04]
Gender: Female, Male. Age: 18-64 years, 65+ years. Enrolment: 150.
Start date (EU): 2023-01-13. Decision date: 2024-05-30. Results received: No. Last updated: 2026-05-06.
Decision dates by country: DK: 2024-05-30, DE: 2024-06-03, IT: 2024-06-03, FR: 2024-05-30, GR: 2024-07-08, PL: 2024-06-03, ES: 2024-06-03

Condition(s): Previously Untreated Locally Advanced or Metastatic Urothelial Cancer
Product: Tiragolumab, Tecentriq 1 200 mg concentrate for solution for infusion, RO7247669

Primary endpoint: 1. Incidence and severity of adverse events, with severity determined according to national cancer institute common terminology criteria for adverse events, version 5.0 (NCI CTCAE v5), with the exception of Cytokine Release Syndrome (CRS) event severity which will be determined according to the American Society for Transplantation and Cellular Therapy (ASTCT)

Source: https://euclinicaltrials.eu/ctis-public/view/2023-504027-78-00